EU clinical trial 2023-503606-36-00: Choice Of the Most Active Strategies for Short term recurring Triple Negative Breast Cancer A phase Ib/II, open-label, modular, dose-finding and dose-expansion study to explore safety, tolerability, pharmacokinetics, and anti-tumor activity of novel therapeutics in patients with early relapsed metastatic triple-negative breast cancer
Protocol code: CSET 2022-3571
Sponsor: Institut Gustave Roussy (Hospital/Clinic/Other health care facility). Phase: Phase I and Phase II (Integrated)- Other. Countries: France (ongoing, recruiting).
Therapeutic area(s): Diseases [C] - Neoplasms [C04]
Gender: Female, Male. Age: 18-64 years, 65+ years. Enrolment: 50.
Status: Ongoing, recruiting. Start date (EU): 2024-06-17. Decision date: 2024-01-15. Results received: No. Last updated: 2026-04-24.

Condition(s): Patients with hormone-receptor negative and HER2-negative (IHC 0, 1+ or IHC 2+/ISH-) breast cancer with early relapse while on (neo) adjuvant systemic treatment or within 12 months from the end of all treatments with curative intent.

Source: https://euclinicaltrials.eu/ctis-public/view/2023-503606-36-00